EU clinical trial 2023-509348-84-00: A Randomized, Multicenter, Open-Label, 3 Arm Phase 3 Study of Obinutuzumab in Combination with Chlorambucil, ACP 196 in Combination with Obinutuzumab, and ACP-196 Monotherapy in Subjects with Previously Untreated Chronic Lymphocytic Leukemia
Protocol code: ACE-CL-007
Sponsor: Acerta Pharma B.V. (Pharmaceutical company). Phase: Therapeutic confirmatory (Phase III). Countries: France (ended), Lithuania (ended), Italy (ended), Poland (ended), Belgium (ended), Spain (ended), Sweden (ended), Germany (ended), Hungary (ongoing, recruitment ended).
Therapeutic area(s): Diseases [C] - Neoplasms [C04]
Gender: Female, Male. Age: 18-64 years, 65+ years. Enrolment: 212.
Start date (EU): 2015-04-27. Decision date: 2024-07-11. Results received: No. Last updated: 2026-07-20.
Decision dates by country: ES: 2024-07-11, IT: 2024-07-16, LT: 2024-07-24, SE: 2024-07-12, PL: 2024-08-04, BE: 2024-07-18, FR: 2024-07-22, DE: 2024-07-19, HU: 2024-07-17

Condition(s): Chronic Lymphocytic Leukemia
Product: Calquence 100 mg hard capsules, Gazyvaro 1,000 mg concentrate for solution for infusion., Chlorambucil 2 mg tablets, Calquence 100 mg film-coated tablets

Primary endpoint: The primary endpoint of the study is PFS as assessed by IRC review per IWCLL 2008 criteria. The primary analysis is a comparison of PFS between Arm A and Arm B.
Endpoint(s): "Efficacy: The first secondary endpoint is a comparison of IRC-assessed PFS between Arm A and Arm C. Other secondary endpoints are as follows and compare Arm A versus Arm B and Arm A versus Arm C • OS. Safety: • Frequency, severity, and relatedness of adverse events. • Frequency of adverse events requiring discontinuation of study drug or dose reductions. • Change in laboratory assessments. ", Efficacy: The first secondary endpoint is a comparison of IRC-assessed PFS between Arm A and Arm C. Other secondary endpoints are as follows and compare Arm A versus Arm B and Arm A versus Arm C • OS. Safety: • Frequency, severity, and relatedness of adverse events. • Frequency of adverse events requiring discontinuation of study drug or dose reductions. • Change in laboratory assessments.

Source: https://euclinicaltrials.eu/ctis-public/view/2023-509348-84-00